EU clinical trial 2024-520445-23-00: Efficacy and safety of NNC0487-0111 s.c. once-weekly in participants with overweight or obesity, and knee osteoarthritis (AMAZE 6)
Protocol code: NN9490-8294
Sponsor: Novo Nordisk A/S (Pharmaceutical company). Phase: Therapeutic confirmatory (Phase III). Countries: Greece (ongoing, recruiting), Poland (ongoing, recruiting), Spain (ongoing, recruiting), Bulgaria (ongoing, recruiting), Italy (ongoing, recruiting), Denmark (ongoing, recruiting).
Therapeutic area(s): Diseases [C] - Nutritional and Metabolic Diseases [C18]
Gender: Female, Male. Age: 18-64 years, 65+ years. Enrolment: 220.
Status: Ongoing, recruiting. Start date (EU): 2026-04-15. Decision date: 2026-04-07. Results received: No. Last updated: 2026-04-14.
Decision dates by country: BG: 2026-04-14, DK: 2026-04-07, GR: 2026-04-08, IT: 2026-04-10, ES: 2026-04-10, PL: 2026-04-09

Condition(s): Overweight or obesity, and knee osteoarthritis
Product: Placebo, NNC0487-0111 B 10145, NNC0487-0111 B 10146, NNC0487-0111 B 10142, NNC0487-0111 B 10143, NNC0487-0111 B 10141, NNC0487-0111 B 10144

Primary endpoint: Relative change in body weight, Change in WOMAC Osteoarthritis Index NRS 3.1 (24-hour) (WOMAC) pain score
Endpoint(s): CCI, CCI, Change in WOMAC physical function scorea, Change in SF-36v2® Health Survey Acute (SF-36v2 Acute) physical functioning score, Change in body weight, Change in body mass index (BMI), Change in WOMAC stiffness score, Change in WOMAC total score, CCI, Change in waist circumference, Change in systolic blood pressure (SBP), Change in diastolic blood pressure (DBP), Change in lipids: Total cholesterol High-density lipoprotein (HDL) cholesterol Low-density lipoprotein (LDL) cholesterol Very low-density lipoprotein (VLDL) cholesterol Non-HDL cholesterol Triglycerides, Change in high-sensitivity C-reactive protein (hsCRP), Change in glycated haemoglobin (HbA1c), Change in fasting plasma glucose (FPG), Use of allowed rescue analgesics during washout period (Yes/no), Amount of allowed rescue analgesics used during washout period, Use of pain medication (Yes/No), Amount of pain medication used, Change in pain medication (decrease/no change/increase), Change in knee pain intensity (NRS), Number of: Treatment Emergent Adverse Events (TEAEs) Treatment Emergent Serious Adverse Events (TESAEs) TEAEs leading to permanent treatment discontinuation

Source: https://euclinicaltrials.eu/ctis-public/view/2024-520445-23-00